EU clinical trial 2024-512503-39-00: MRD registry and multicenter, randomized controlled pragmatic trial of standard intensity versus reduced intensity consolidation treatment in MRD-negative patients with AML or CLL (RESOLVE trial).
Protocol code: RESOLVE trial
Sponsor: Medizinische Hochschule Hannover (Educational Institution). Phase: Therapeutic use (Phase IV). Countries: France (ongoing, recruiting), Germany (ongoing, recruiting), Poland (authorised, recruitment pending).
Therapeutic area(s): Diseases [C] - Hemic and Lymphatic Diseases [C15]
Gender: Female, Male. Age: 18-64 years, 65+ years. Enrolment: 289.
Start date (EU): 2025-12-19. Decision date: 2025-07-07. Results received: No. Last updated: 2026-03-09.
Decision dates by country: FR: 2025-07-07, DE: 2026-03-09, PL: 2026-03-07

Condition(s): Arm A (AML): Newly diagnosed de novo Acute myeloid leukemia (AML) or MDS/AML (MDS = Myelodysplastic syndrome) patients according to ICC 2022 or newly diagnosed AML or MDS-IB2 patients according to WHO 2022 classifications; Arm B (CLL): Chronic lymphocytic leukemia (CLL) or small lymphocytic lymphoma (SLL)
Product: MITOXANTRONE, CYTARABINE, IDARUBICIN, OBINUTUZUMAB, DAUNORUBICIN, GEMTUZUMAB OZOGAMICIN, TREOSULFAN, BUSULFAN, QUIZARTINIB, FLUDARABINE, VENETOCLAX, THIOTEPA, MIDOSTAURIN, IBRUTINIB, CYTARABINE AND DAUNORUBICIN, ETOPOSIDE, CLADRIBINE, CYCLOPHOSPHAMIDE

Primary endpoint: MRD registry, Arm A (AML): Frequency of MRD negative CR/CRi/CRh in AML patients after 1-2 cycles with standard induction therapy., MRD registry, Arm B (CLL): Frequency of uMRD at first on-treatment MRD assessment (VEN + anti-CD20 MoAb: C7D1 after treatment start; VEN + BTKi ibrutinib: C9D1 after treatment start), RESOLVE trial, Arm A (AML): Overall survival (OS), RESOLVE trial, Arm B (CLL): Average overall adverse event burden score based on physician assessment during the period from randomization to AE score 03 assessment (C14D1 for venetoclax + moAB treated patients; C16D1 for venetoclax + BTKi ibrutinib treated patients).
Endpoint(s): MRD registry, Arm A (AML): Rate of CR defined by ELN 2022 after 1-2 cycles of chemotherapy., MRD registry, Arm A (AML): Rate of CR with incomplete hematologic recovery (CRi) rate defined by ELN 2022 after 1-2 cycles of chemotherapy., MRD registry, Arm A (AML): Rate of CR with partial hematologic recovery (CRh) rate defined by ELN 2022 after 1-2 cycles of chemotherapy., MRD registry, Arm A (AML): Rate of morphologic leukemia-free state (MLFS) defined by ELN 2022 after 1-2 cycles of chemotherapy., MRD registry, Arm A (AML): Frequency of reasons for non-participation in the RESOLVE trial., MRD registry, Arm B (CLL): Rate of uMRD in peripheral blood at the time of MRD1 and MRD2 assessments., MRD registry, Arm B (CLL): Frequency of reasons for non-participation in the RESOLVE trial., RESOLVE trial, Arm A (AML): GvHD-free-relapse-free survival (GRFS) in groups 1 and 2 measured from the date of randomization until the date of hematologic relapse or death from any cause or grade III–IV acute GvHD or chronic GVHD that requires systemic treatment, RESOLVE trial, Arm A (AML): Cumulative incidence of relapse (CIR) in groups 1 and 2 measured from the date of achievement of a remission until the date of hematologic relapse; patients not known to have relapsed are censored on the date they were last assessed for response; death without relapse will be considered as competing event., RESOLVE trial, Arm A (AML): Cumulative incidence of non-relapse mortality (CID) in groups 1 and 2 defined as death in CR/CRi/CRh/MLFS and measured from randomization to death with relapse as a competing event. Patients who are not known to have relapsed or died will be censored at the date of last response assessment., RESOLVE trial, Arm B (CLL): Average overall adverse event burden score based on physician assessment excluding laboratory AEs from randomization to AE score 3 assessment (C14D1 for venetoclax + moAb treated patients; C16D1 for venetoclax + BTKi ibrutinib treated patients)., RESOLVE trial, Arm B (CLL): Duration of response (DOR) measured from randomization to the date that disease progression is objectively documented or death, whichever occurs first., RESOLVE trial, Arm B (CLL): 3-year progression-free survival (PFS) measured from randomization until the date of disease progression or death from any cause.

Source: https://euclinicaltrials.eu/ctis-public/view/2024-512503-39-00